EU clinical trial 2024-513724-42-00: An International Prospective Study in Children Older than 3 to 5 Years with Clinically Standard-Risk Medulloblastoma with Low-Risk Biological Profile (PNET 5 MB – LR and PNET 5 MB – WNT-HR), average-risk biological profile (PNET 5 MB -SR), or TP53 mutation, and registry for MB ocurring in the context of genetic predisposition
Protocol code: PNET 5 MB
Sponsor: University Medical Center Hamburg-Eppendorf (Hospital/Clinic/Other health care facility). Phase: Phase II and Phase III (Integrated). Countries: Spain (ongoing, recruiting), Netherlands (ongoing, recruiting), Czechia (ongoing, recruiting), Sweden (ongoing, recruiting), Belgium (ongoing, recruiting), Finland (ongoing, recruiting), France (ongoing, recruiting), Germany (ongoing, recruiting), Austria (ongoing, recruiting), Italy (ongoing, recruiting).
Therapeutic area(s): Diseases [C] - Neoplasms [C04]
Gender: Female, Male. Age: 0-17 years, 18-64 years. Enrolment: 359.
Status: Ongoing, recruiting. Start date (EU): 2024-09-26. Decision date: 2024-09-26. Results received: No. Last updated: 2026-05-18.
Decision dates by country: AT: 2024-11-12, BE: 2024-09-27, CZ: 2024-09-26, FI: 2024-09-30, FR: 2024-10-09, DE: 2024-10-10, ES: 2024-09-27, SE: 2024-09-27, NL: 2024-09-26, IT: 2024-10-07

Condition(s): Medulloblastoma
Product: DOXORUBICIN HYDROCHLORIDE, VINCRISTINE, METHOTREXATE, LOMUSTINE, CISPLATIN, VINBLASTINE SULFATE, METHOTREXATE, CARBOPLATIN, CYCLOPHOSPHAMIDE

Primary endpoint: All arms: The primary outcome measure is event-free survival (EFS).
Endpoint(s): All arms: The rate of overall survival (OS), and the rate of progression-free survival (PFS), estimated by the Kaplan-Meier method, are secondary outcome measures., All arms: Pattern of relapse is a secondary outcome measure. The site and time to local progression will be the measures for local tumour control. Particular attention will be given to posterior fossa relapse, i.e. local relapse within the tumour bed, or metastatic relapse to the posterior fossa outside the tumour bed. The time period begins on the date of surgery and ends on the date of appearance of relapse/progression. The appearance of metastases will not be regarded as local progression., SR: Feasibility of carboplatin treatment concomitantly to radiotherapy is a secondary outcome measure. The timely delivery of maintenance chemotherapy, the number of interruption days, and the grade of weight change, dysphagia and esophagitis, transfusion requirement, haematological toxicities, and infection during therapy, as well as ototoxicity are measures of the feasibility of additional carboplatin., All arms: Indirect measures of quality of survival (QoS) are a secondary outcome measure. Standardized, patients/ parents rated scales for measurement of health status (HUI3), executive function (BRIEF), behavioural outcome (SDQ), medical, educational, employment and social situation (MEES), Fatigue (PedsQL Multidimensional Fatigue Scale and, in adults, the MFI), and quality of life (PedsQL and, in adults, the QLQ-C30) will be the indirect measures for QoS., All arms: Audiological toxicity is a secondary outcome measure. The extent of ototoxicity based dose modifications of maintenance chemotherapy, as well as the results of Pure Tone Audiometry (PTA) graded by the Chang criteria evaluated 2 years after diagnosis will be the measures for audiological toxicity., All arms: Endocrine function is a secondary outcome measure. FSH levels (cut-off level >15 IU/l) will be used as biomarker for subfertility. Growth retardation will be calculated as the difference in height standard deviation score (sds) from diagnosis, and the need for, time to, and duration of hormone supplementation will be used as surrogate markers for endocrine deficits. All measures will be evaluated 2 and 5 years from diagnosis/surgery and again in adulthood at 18 years., All arms: Neurological function is an outcome measure. The occurrence and severity of posterior fossa syndrome (as measured by the cerebellar mutism syndrome survey), and the occurrence and severity of persisting cerebellar symptoms (measured by the brief ataxia rating scale) will be the measures for neurological function., All arms: The prognostic value of biological tumour markers is an outcome measure. Results of protein expression (including immunohistochemistry), RNA expression, and DNA analysis assays undertaken on tumour, blood or CSF material will be the measures for biological properties., SHH-TP53: Response rate, SHH-TP53: Duration of response, SHH-TP53: Incidence of secondary malignancies, SHH-TP53: Incidence of local, metastastatic and combined relapses in relation to radiation field (inside or outside of radiation field), SHH-TP53: Incidence of somatic, germline, and mosaic TP53 mutations

Source: https://euclinicaltrials.eu/ctis-public/view/2024-513724-42-00